EU clinical trial 2022-503133-54-00: A Phase I/II First-In-Human Clinical Trial to Evaluate the Safety, Tolerability and Anti-Tumor Activity of IMA402, a Bispecific T Cell-Engaging Receptor Molecule (TCER®) targeting PRAME, as Monotherapy or in Combination with a Checkpoint Inhibitor in Patients with Recurrent and/or Refractory Solid Tumors
Protocol code: IMA402-101
Sponsor: Immatics Biotechnologies GmbH (Pharmaceutical company). Phase: Phase I and Phase II (Integrated)- First administration to humans. Countries: Germany (ongoing, recruiting), Netherlands (ongoing, recruiting).
Therapeutic area(s): Diseases [C] - Neoplasms [C04]
Gender: Female, Male. Age: 18-64 years, 65+ years. Enrolment: 375.
Status: Ongoing, recruiting. Start date (EU): 2023-08-09. Decision date: 2023-07-17. Results received: No. Last updated: 2026-05-26.
Decision dates by country: NL: 2024-08-12, DE: 2023-07-17

Condition(s): Solid Tumors
Product: DECITABINE, HUMAN SERUM ALBUMIN, IMA402, TOCILIZUMAB, IMA401

Primary endpoint: Number of patients with dose-limiting toxicities (Phase Ia), Number of patients with treatment-emergent adverse events (TEAEs) (Phase I/II), Number of patients with serious TEAEs (Phase I/II), Frequency and duration of dose interruptions and reductions, permanent discontinuations (Phase I/II), Objective response rate based on best overall response of complete response and partial response locally assessed using RECIST 1.1 (Phase II)

Source: https://euclinicaltrials.eu/ctis-public/view/2022-503133-54-00